EU clinical trial 2023-510312-40-00: Active vitamin D for secondary hyperparathyroidism after bariatric surgery: a multicenter randomized controlled trial (ActiVitD)
Sponsor: Academisch Ziekenhuis Leiden (Hospital/Clinic/Other health care facility). Phase: Therapeutic use (Phase IV). Countries: Netherlands (ongoing, recruiting).
Therapeutic area(s): Diseases [C] - Hormonal diseases [C19]
Gender: Female, Male. Age: 18-64 years, 65+ years. Enrolment: 130.
Status: Ongoing, recruiting. Start date (EU): 2024-11-04. Decision date: 2024-11-04. Results received: No. Last updated: 2024-11-04.

Condition(s): Secondary hyperparathyroidism
Product: Etalpha 0,5 microgram zachte capsules, Etalpha 0,25 microgram zachte capsules, Etalpha 1 microgram zachte capsules

Primary endpoint: Normalization of PTH (and thus recovery of secondary hyperparathyroidism) at 2 years after diagnosis and start of treatment in one of the study groups. Secondary hyperparathyroidism will be defined as PTH at the upper limit or above the labs reference value combined with a normal or decreased serum calcium level (in patients with 25(OH)D >50 nmol/L
Endpoint(s): Decrease in BMD (defined as 3% decrease in T-score at the lumbar spine and 5% decrease in T-score at the hip / forearm), measured at 1 and 2 years after inclusion, Quality of life is measured after inclusion and thereafter every 6 months with the OBESI-Q questionnaire

Source: https://euclinicaltrials.eu/ctis-public/view/2023-510312-40-00